EU clinical trial 2024-511975-14-00: A5481092: PHASE 1/2 STUDY TO EVALUATE PALBOCICLIB (IBRANCE®) IN COMBINATION WITH IRINOTECAN AND TEMOZOLOMIDE OR IN COMBINATION WITH TOPOTECAN AND CYCLOPHOSPHAMIDE IN PEDIATRIC PATIENTS WITH RECURRENT OR REFRACTORY SOLID TUMORS
Protocol code: A5481092
Sponsor: Pfizer Inc. (Pharmaceutical company). Phase: Phase I and Phase II (Integrated)- Other. Countries: Sweden (ended), France (ended), Czechia (ended), Slovakia (ended), Germany (ended).
Therapeutic area(s): Diseases [C] - Neoplasms [C04]
Gender: Female, Male. Age: 0-17 years, 18-64 years. Enrolment: 29.
Status: Ended. Start date (EU): 2022-05-26. End date (EU): 2025-08-06. End date: 2025-08-07. Decision date: 2024-08-20. Results received: Yes. Last updated: 2025-09-08.
Decision dates by country: FR: 2024-09-06, DE: 2024-08-21, SE: 2024-08-21, CZ: 2024-08-21, SK: 2024-08-20

Condition(s): recurrent/refractory Ewing sarcoma, recurrent or refractory neuroblastoma
Product: Irinotecan Hikma 20 mg/ml Konzentrat zur Herstellung einer Infusionslösung, PALBOCICLIB, Palbociclib, TEMOZOLOMIDE, TEMOZOLOMIDE, PALBOCICLIB, PALBOCICLIB, TEMOZOLOMIDE, Temozolomide SUN 5 mg hard capsules, Endoxan®, TOPOTECANE ACCORD 1 mg/ml, solution à diluer pour perfusion

Primary endpoint: Event-free survival based on investigator assessment. Tumor Specific Cohorts: - AEs as characterized by type, frequency, severity (as graded by NCI CTCAE version 4.03), timing, seriousness, and relationship to study therapy; laboratory test data including HbA1c as characterized by type, frequency, severity (as graded by NCI CTCAE version 4.03), and timing; ECG parameters, and vital signs.
Endpoint(s): Event-free survival (EFS) assessed by an independent review committee., Objective response (OR), as assessed by investigator using Response Evaluation Criteria in Solid Tumors (RECIST) version 1.1., PET-CT response after cycle 4 compared to objective response onMRI/CT., Progression free survival (PFS) based on investigator assessment., Overall survival (OS)., Adverse Events (AEs) as graded by National Cancer Institute (NCI) Common Terminology Criteria for Adverse events (CTCAE) version 4.03., Pharmacokinetic parameters of palbociclib, TMZ, IRN: -Palbociclib PK: MD (assuming steady state is achieved) - Css,max, Tmax, AUCss, τ, Css,trough, and CL/F, as data permit. -TMZ PK: MD - Css,max, Tmax, AUCss, τ, Css,trough, and CL/F, as data permit. -IRN (and active metabolite, SN-38) PK: MD - Css,max, Tmax, AUCss, τ, Css,trough, and CL/F, as data permit., QoL reported by patient at baseline and after 2 and 4 cycles using ageappropriate tools., Days of hospitalization, Tumor-Specific Cohorts: -DOR, PFS, and OS. -Pharmacokinetic parameters of palbociclib,TMZ, IRN (and active metabolite, SN-38), TOPO and CTX - PK: MD - Css,max, Tmax, AUCss, τ, Css,trough, and CL/F, as data permit.

Source: https://euclinicaltrials.eu/ctis-public/view/2024-511975-14-00